EU clinical trial 2023-506135-14-00: Optimizing extended adjuvant endocrine therapy in patients with breast cancer: a registry-based randomized clinical trial
Sponsor: Region Oerebro Laen (Hospital/Clinic/Other health care facility). Phase: Phase III and phase IV (Integrated). Countries: Sweden (ongoing, recruiting).
Therapeutic area(s): Diseases [C] - Neoplasms [C04]
Gender: Female. Age: 18-64 years, 65+ years. Enrolment: 3832.
Status: Ongoing, recruiting. Start date (EU): 2025-09-10. Decision date: 2023-10-12. Results received: No. Last updated: 2024-11-15.

Condition(s): Breast cancer
Product: EXEMESTANE, ANASTROZOLE, TAMOXIFEN, LETROZOLE

Primary endpoint: Overall survival
Endpoint(s): Invasive disease-free survival; distant disease-free survival; breast cancer-specific survival; toxicity (grade 3 or 4); quality of Life; adherence; healthcare resource utilization; sick leave and early retirement

Source: https://euclinicaltrials.eu/ctis-public/view/2023-506135-14-00